EU clinical trial 2025-522349-23-00: Post-INFECT: Investigating Neuroinflammation and its eFEcts in post-COVID syndrome: an imaging sTudy
Sponsor: Amsterdam UMC Stichting (Patient organisation/association). Phase: Therapeutic confirmatory (Phase III). Countries: Netherlands (authorised, recruiting).
Therapeutic area(s): Diseases [C] - Virus Diseases [C02]
Gender: Female, Male. Age: 18-64 years. Enrolment: 65.
Status: Authorised, recruiting. Start date (EU): 2026-07-05. Decision date: 2026-06-01. Results received: No. Last updated: 2026-06-01.

Condition(s): post-COVID syndrome
Product: Fludeoxyglucose (18F)-Curium, 185 MBq/ml oplossing voor injectie.

Primary endpoint: Cellular metabolism in the brain as measured with dynamic [18F]FDG PET, Structural and functional parameters of the brain as measured with MRI, Immune-related blood parameters
Endpoint(s): Presence and severity of symptoms as measured with questionnaires

Source: https://euclinicaltrials.eu/ctis-public/view/2025-522349-23-00